EU clinical trial 2024-518897-15-00: THE IMPACT OF VITAMIN D3 HIGH DOSES SUPPLEMENTATION ON SOFT TISSUE WOUND HEALING AFTER MANDIBULAR THIRD MOLAR (M3) REMOVAL: A PILOT STUDY
Protocol code: VitDM3BH
Sponsor: Medical University Of Vienna (Educational Institution). Phase: Therapeutic exploratory (Phase II). Countries: Austria (ongoing, recruiting).
Therapeutic area(s): Diseases [C] - Stomatognathic Diseases [C07]
Gender: Female, Male. Age: 18-64 years. Enrolment: 20.
Status: Ongoing, recruiting. Start date (EU): 2021-07-07. Decision date: 2024-12-10. Results received: No. Last updated: 2025-08-29.

Condition(s): Vitamin D insufficiency undergoing tooth extraction
Product: COLECALCIFEROL

Primary endpoint: mean total IPR scores and subscores for the different wound healing phases between without (first extracted upper third molar) and with vitamin D3 intervention (second extracted upper third molar), mean salivary levels of IL-1β, IL-8, and MRP-8/14 and the dynamic of their alteration between without (first extracted upper third molar) and with vitamin D3 intervention (second extracted upper third molar), serum level of 25(OH)D3 changes in healthy participants after the vitamin D3 supplementation, frequency and severity of adverse events (AE)
Endpoint(s): to assess the salivary levels of several pro-inflammatory mediators, particularly interleukin (IL)-1b, IL-8, and myeloid-related protein (MRP)-8/14, measured before and at different time points after wisdom tooth extraction with and without previous vitamin D3 supplementation and to compare the time course of the inflammatory reaction.

Source: https://euclinicaltrials.eu/ctis-public/view/2024-518897-15-00